EU clinical trial 2023-505394-32-00: A randomized, double-blind, multicenter, Phase 3 study to evaluate efficacy and safety of belumosudil in combination with corticosteroids versus placebo in combination with corticosteroids in participants at least 12 years of age with newly diagnosed chronic graft versus host disease (cGVHD)
Protocol code: EFC17757
Sponsor: Sanofi-Aventis Research & Development (Pharmaceutical company). Phase: Therapeutic confirmatory (Phase III). Countries: Belgium (ongoing, recruitment ended), Sweden (ended), Netherlands (ongoing, recruitment ended), Germany (ended), Denmark (ended), Spain (ongoing, recruitment ended), Austria (ended), Poland (ongoing, recruitment ended), Portugal (ended), Greece (ongoing, recruitment ended), France (ongoing, recruitment ended), Italy (ended), Czechia (ended).
Therapeutic area(s): Diseases [C] - Immune System Diseases [C20]
Gender: Female, Male. Age: 0-17 years, 18-64 years, 65+ years. Enrolment: 157.
Start date (EU): 2025-02-06. Decision date: 2024-02-12. Results received: No. Last updated: 2026-02-17.
Decision dates by country: DK: 2024-02-12, PT: 2024-06-04, DE: 2024-02-13, CZ: 2024-02-13, AT: 2024-02-19, SE: 2024-02-16, FR: 2024-06-07, BE: 2024-02-13, IT: 2024-02-15, ES: 2024-02-13, GR: 2024-02-16, PL: 2024-02-16, NL: 2024-02-19

Condition(s): chronic graft versus host disease
Product: same excipients except no hypromellose, PREDNISONE, SAR445761 - belumosudil, PREDNISOLONE

Primary endpoint: Event-Free Survival (EFS) from the date of randomization to the date of any predefined event, whichever occurs first
Endpoint(s): Proportion of participants who achieve a clinically relevant reduction in mLSS of at least 6 points from baseline (Only in participants at least 18 years of age), Proportion of participants who achieve an overall response (PR or CR) as per 2014 NIH consensus response criteria by 48 weeks and maintained the response for a duration of at least 6 months, Proportion of participants who successfully discontinue all systemic corticosteroids for cGVHD for at least 30 days before the occurrence of cGVHD progression, or start of a new systemic treatment for cGVHD, relapse or recurrence of the underlying disease, or unacceptable toxicity, Proportion of participants who achieve an overall response (CR or PR) as per 2014 NIH consensus response criteria at any time before the start of new systemic treatment for cGVHD, Proportion of participants who achieve an overall response (CR or PR) as per 2014 NIH consensus response criteria at any time before the start of new systemic treatment for cGVHD, Time from the date of the first response to the date of cGVHD progression, start of new systemic treatment for cGVHD, or death, whichever occurs first. DOR is determined only for participants who achieved overall response (PR or CR) as per 2014 NIH consensus response criteria, Proportion of participants with a reduction in daily corticosteroid dose, Failure Free Survival (FFS) is defined as the time from the date of randomization to the date of start of a new systemic treatment for cGVHD, relapse or recurrence of the underlying disease, or death, whichever occurs first., Change from baseline in Patient-Reported Outcomes Measurement Information System Global Health (PROMIS-GH) (Only in participants at least 18 years of age) and the European Quality of Life Group Questionnaire with 5 Dimensions and 5 Levels (EQ5D5L), Number of participants with treatment-emergent adverse events [TEAEs], serious TEAEs, and adverse events of special interest (AESIs), The time from the date of randomization to the date of death due to any cause, Time to Response is defined as the time from randomization to the date the patient has first response (CR or PR)., Proportion of participants who achieve CR or PR as per NIH consensus response criteria (2014) at any time point in each involved organ and before the start of a new systemic therapy for cGVHD.

Source: https://euclinicaltrials.eu/ctis-public/view/2023-505394-32-00